EU clinical trial 2024-511757-21-00: Study of EGF816 in combination with selected targeted agents in EGFR-mutant NSCLC.
Protocol code: CEGF816X2102
Sponsor: Novartis Pharma AG (Pharmaceutical company). Phase: Human Pharmacology (Phase I)- Other. Countries: Italy (ended), Germany (ongoing, recruitment ended).
Therapeutic area(s): Diseases [C] - Neoplasms [C04]
Gender: Female, Male. Age: 18-64 years, 65+ years. Enrolment: 52.
Start date (EU): 2024-12-20. Decision date: 2024-07-05. Results received: No. Last updated: 2026-02-12.
Decision dates by country: IT: 2024-08-16, DE: 2024-07-05

Condition(s): Patients with EGFR-mutant Non Small Cell Lung Cancer

Source: https://euclinicaltrials.eu/ctis-public/view/2024-511757-21-00